EU clinical trial 2024-512860-75-00: (NFPET) ‘89Zr-Bevacizumab PET/CT imaging of vestibular schwannomas for the prediction of bevacizumab treatment effect in patients with symptomatic neurofibromatosis type 2
Sponsor: Leids Universitair Medisch Centrum (LUMC) (Hospital/Clinic/Other health care facility). Phase: Therapeutic exploratory (Phase II). Countries: Netherlands (ongoing, recruiting).
Therapeutic area(s): Diseases [C] - Nervous System Diseases [C10]; Diseases [C] - Neoplasms [C04]; Diseases [C] - Otorhinolaryngologic Diseases [C09]
Gender: Female, Male. Age: 18-64 years, 65+ years. Enrolment: 24.
Status: Ongoing, recruiting. Start date (EU): 2024-10-01. Decision date: 2024-10-01. Results received: No. Last updated: 2024-10-01.

Condition(s): NF2-related schwannomatosis
Product: 89Zr-Bevacizumab

Primary endpoint: The correlation of the results of the pre-treatment 89Zr- Bevacizumab with the proportion of patients with confirmed hearing response (HR) and radiographic response (RR) to bevacizumab therapy.
Endpoint(s): Correlations of pre-treatment 89Zr-Bevacizumab PET/CT imaging with patient-reported outcome measures (PROM), vestibular function, cranial nerve (dys)function, kidney function and nontarget schwannoma response after bevacizumab treatment in NF2-patients.

Source: https://euclinicaltrials.eu/ctis-public/view/2024-512860-75-00